EU clinical trial 2023-508731-31-01: Understanding the Neurobiology of Pharmacologically-induced Acute Stress on Ethical Decisions
Sponsor: Universitair Medisch Centrum Utrecht (Hospital/Clinic/Other health care facility). Phase: Therapeutic use (Phase IV). Countries: Netherlands (ended).
Therapeutic area(s): Psychiatry and Psychology [F] - Behavior and Behavior Mechanisms [F01]
Gender: Female, Male. Age: 18-64 years. Enrolment: 100.
Status: Ended. Start date (EU): 2024-07-18. End date (EU): 2025-06-30. Decision date: 2024-04-25. Results received: No. Last updated: 2025-03-24.

Condition(s): Mimic an acute stress response in humans.
Product: CELLULOSE, MICROCRYSTALLINE, YOCORAL 5 mg tabletten, Hydrocortison Teva 10 mg, filmomhulde tabletten

Primary endpoint: The number of utilitarian, deontological, and compromise choices made in a behavioural task measuring moral judgement., The number of violations in rationality when making moral decisions.
Endpoint(s): The total score of the forward, backward, and sequencing digit span of the Digit Span Task, an assessment of working memory., The stop signal reaction time of the Stop Signal Task, assessment of impulse control., The mean adjusted amount of button clicks and total number of exploded balloons for each risk condition in the Balloon Analogue Risk Taking task, assessment for risk-taking.

Source: https://euclinicaltrials.eu/ctis-public/view/2023-508731-31-01